EU clinical trial 2023-509618-12-00: A Phase 3 Multicenter Study to Evaluate Efficacy, Safety, and Pharmacokinetics of Upadacitinib with Open-Label Induction, Randomized, Double-Blind Maintenance and Open-Label Long-Term Extension in Pediatric Subjects with Moderately to Severely Active Crohn's Disease and Inadequate Response, Intolerance, or Medical Contraindications to Corticosteroids, Immunosuppressants, and/or Biologic Therapy
Protocol code: M14-671
Sponsor: AbbVie Deutschland GmbH & Co. KG (Pharmaceutical company). Phase: Therapeutic confirmatory (Phase III). Countries: France (ongoing, recruiting), Greece (authorised, recruiting), Belgium (ongoing, recruiting), Poland (ongoing, recruiting), Bulgaria (authorised, recruiting), Italy (ongoing, recruiting), Spain (ongoing, recruiting).
Therapeutic area(s): Diseases [C] - Digestive System Diseases [C06]
Gender: Female, Male. Age: 0-17 years. Enrolment: 21.
Start date (EU): 2024-09-11. Decision date: 2024-08-05. Results received: No. Last updated: 2026-06-10.
Decision dates by country: ES: 2024-09-26, PL: 2024-08-06, GR: 2024-08-07, FR: 2024-08-06, IT: 2024-08-06, BE: 2024-08-05, BG: 2024-08-05

Condition(s): Crohn's Disease (CD)
Product: Upadacitinib, Upadacitinib, METHOTREXATE, Upadacitinib, Upadacitinib, CIPROFLOXACIN, DEXAMETHASONE, SULFASALAZINE, Upadacitinib

Primary endpoint: Achievement of clinical remission per the Pediatric Crohn's Disease Activity Index (PCDAI) at Week 64 in the participants who achieved clinical response per PCDAI at Week 12, Achievement of endoscopic response at Week 64 in participants who achieved clinical response per PCDAI at Week 12., Number of Participants with Adverse Events
Endpoint(s): Achievement of clinical remission per PCDAI at week 12, Achievement of endoscopic response at week 12, Achievement of endoscopic remission at week 12, Achievement of clinical response per PCDAI at week 12, Achievement of clinical response per PCDAI at week 64 in participants who achieved clinical response per PCDAI at Week 12, Achievement of endoscopic remission at Week 64 in participants who achieved clinical response per PCDAI at Week 12, Achievement of corticosteroid (CS)-free clinical remission per PCDAI at Week 64 in participants who achieved clinical response per PCDAI at Week 12

Source: https://euclinicaltrials.eu/ctis-public/view/2023-509618-12-00